EU clinical trial 2023-509963-25-00: FUDOSE: Dihydropyrimidine dehydrogenase (DPD) phenotype-guided dose individualization of fluoropyrimidinebased chemotherapy in DPD deficient patients with gastrointestinal cancers.
Protocol code: UC-GIG-2311
Sponsor: Unicancer (Hospital/Clinic/Other health care facility). Phase: Therapeutic exploratory (Phase II). Countries: France (ongoing, recruiting).
Therapeutic area(s): Diseases [C] - Neoplasms [C04]
Gender: Female, Male. Age: 18-64 years, 65+ years. Enrolment: 400.
Status: Ongoing, recruiting. Start date (EU): 2025-01-17. Decision date: 2024-11-20. Results received: No. Last updated: 2026-02-05.

Condition(s): Fluoropyrimidine (FP)-naive patients with gastrointestinal (GI) cancer and available pre-treatment uracilemia ([U]) starting chemotherapy combining FP (5FU or capecitabine) and oxaliplatin for any indication
Product: CAPECITABINE, OXALIPLATIN, FLUOROURACIL, CAPECITABINE, FOLINIC ACID

Primary endpoint: Proportion of FP-induced grade ≥ 3 haematological and gastrointestinal toxicity after 2 cycles (4 weeks for FOLFOX +/- TT or 6 weeks for 2 CAPOX +/- TT) according to the National Cancer Institute - common terminology criteria for adverse events (NCI CTCAE) version 5.0 in patients treated for a GI cancer in the (neo-)adjuvant or the metastatic setting.
Endpoint(s): The recommended FP dose will be estimated by comparing the rate of FP-induced grade ≥ 3 haematological and gastrointestinal toxicity in each [U]-based group of DPD-deficient patients (according to [U] level) to the one observed in non DPD-deficient patients (control arm) during the first 4 cycles of chemotherapy, Description of FP doses administered during the first 4 chemotherapy cycles in all patients, along with reasons of dose-modifications or treatment discontinuation for limiting toxicity, Percentage of patients in whom FP dose is increased or decreased during the first 4 cycles of chemotherapy, All grade FP-induced toxicities at each cycle 1 to 4, related (neutropenia, febrile neutropenia, anemia, thrombocytopenia, diarrhea, mucositis) or not including (hand-foot syndrome, central neurotoxicity, cardiotoxicity) to DPD-deficiency (NCI CTC-AE). All other FP induced toxicity related or not will be also described., Treatment efficacy will be evaluate in terms of: o DFS defined as the time from surgery to disease recurrence (radiological or clinical) in the subgroup of patients with stage III colon cancer and especially the 3-year DFS., Treatment efficacy will be evaluate in terms of: o OS defined as the time from surgery until death from any cause in the subgroup of patients with stage III colon cancer, Treatment efficacy will be evaluate in terms of: o PFS defined as the time from inclusion to disease progression (radiological or clinical) or death of any cause, whichever occurs first, in the subgroup of patients with stage IV colorectal cancer

Source: https://euclinicaltrials.eu/ctis-public/view/2023-509963-25-00